EU clinical trial 2025-521831-35-00: (23026) A prospective, single-arm, Phase 4 study to evaluate the course of serum transthyretin (TTR) level with acoramidis in adult patients with variant or wild-type transthyretin amyloidosis with cardiomyopathy (ATTR-CM) previously treated with tafamidis.
Protocol code: 23026
Sponsor: Bayer Consumer Care AG (Pharmaceutical company). Phase: Therapeutic use (Phase IV). Countries: Austria (ongoing, recruiting), Germany (authorised, recruitment pending), Italy (ongoing, recruiting), Belgium (authorised, recruitment pending).
Therapeutic area(s): Diseases [C] - Cardiovascular Diseases [C14]
Gender: Female, Male. Age: 18-64 years, 65+ years. Enrolment: 68.
Start date (EU): 2026-02-12. Decision date: 2026-02-07. Results received: No. Last updated: 2026-05-19.
Decision dates by country: DE: 2026-05-07, BE: 2026-05-19, AT: 2026-02-07, IT: 2026-05-19

Condition(s): Transthyretin Amyloid Cardiomyopathy (ATTR-CM)
Product: BEYONTTRA 356 mg film-coated tablets

Primary endpoint: Change in serum TTR level from baseline to month 6 or premature discontinuation of treatment
Endpoint(s): Serum TTR level at baseline, week 1, 2, 3, 4 and at month 3., Occurrence of TEAEs and type of TEAEs and serious TEAEs., Change from baseline to month 6 of NT-proBNP, hs-TnT, hs-CRP, RBP4., Signs of remodeling from baseline to month 6 in ECHO., Change from baseline to month 6 in 6MWD, Change from baseline to month 6 in kidney and thyroid biomarkers: eGFR, Creatinine, Cystatin C, UACR, and TSH., Change from baseline to month 6 in KCCQ-OS score and in EQ-5D-5L index score.

Source: https://euclinicaltrials.eu/ctis-public/view/2025-521831-35-00